EU clinical trial 2024-510795-20-00: Bioequivalence clinical trial of two formulations of edoxaban.
Protocol code: N-EDO-24-285
Sponsor: Laboratorios Normon S.A. (Pharmaceutical company). Phase: Human Pharmacology (Phase I)- Bioequivalence Study. Countries: Spain (ended).
Therapeutic area(s): Not possible to specify
Gender: Female, Male. Age: 18-64 years. Enrolment: 24.
Status: Ended. Start date (EU): 2024-06-11. End date (EU): 2024-07-30. Decision date: 2024-05-14. Results received: No. Last updated: 2024-06-06.
Decision dates by country: ES: 2024-06-06

Condition(s): Healthy volunteers

Source: https://euclinicaltrials.eu/ctis-public/view/2024-510795-20-00